EU clinical trial 2023-507984-20-00: MK-1403 Single Dose Formulation PK Study
Protocol code: MK-1403-003
Sponsor: Merck Sharp & Dohme LLC (Pharmaceutical company). Phase: Human Pharmacology (Phase I)- Other. Countries: Belgium (ended).
Therapeutic area(s): Diseases [C] - Cardiovascular Diseases [C14]
Gender: Male. Age: 18-64 years. Enrolment: 16.
Status: Ended. Start date (EU): 2023-11-17. End date (EU): 2024-03-07. End date: 2024-03-08. Decision date: 2023-11-06. Results received: No. Last updated: 2023-11-21.

Condition(s): Atherosclerosis

Source: https://euclinicaltrials.eu/ctis-public/view/2023-507984-20-00